EU clinical trial 2025-522105-38-00: A Randomized, Open-label, Multicenter, Phase 3 Trial Evaluating Brelovitug vs Delayed Treatment for the Treatment of Chronic Hepatitis Delta Infection (AZURE-4)
Protocol code: BJT-778-304
Sponsor: Mirum Pharmaceuticals Inc. (Pharmaceutical company). Phase: Therapeutic confirmatory (Phase III). Countries: Belgium (ongoing, recruitment ended), Hungary (ongoing, recruitment ended), Bulgaria (ongoing, recruitment ended).
Therapeutic area(s): Diseases [C] - Virus Diseases [C02]
Gender: Female, Male. Age: 18-64 years, 65+ years. Enrolment: 35.
Status: Ongoing, recruitment ended. Start date (EU): 2026-02-02. Decision date: 2025-12-22. Results received: No. Last updated: 2026-08-07.
Decision dates by country: BE: 2025-12-22, HU: 2026-01-07, BG: 2026-01-07

Condition(s): Chronic Hepatitis Delta Infection
Product: BJT-778

Primary endpoint: The proportion of participants who achieve a composite endpoint of virologic response and ALT normalization at Week 24 in brelovitug arms will be compared to response at Week 12 of delayed-treatment arm: • Virologic response is defined as HDV RNA ≥2 log10 IU/mL decrease from Baseline or undetectable HDV RNA • ALT normalization is defined as a decrease in ALT from Baseline to ≤ULN.
Endpoint(s): Safety endpoint will evaluate: •Incidence and severity of treatment-emergent adverse events (TEAE) •Proportion of participants who permanently discontinue treatment due to an adverse event Comparison with delayed treatment will include data through Week 12 (Predose)., The proportion of participants who achieve the following at Week 24, 48, and 96 of treatment unless otherwise specified: • Virologic response defined as ≥2 log10 IU/mL decline from baseline or undetectable HDV RNA • HDV RNA, Proportion of subjects who achieve HDV RNA, Change from Baseline in liver stiffness as determined by transient elastography at Weeks 24, 48, and 96 of brelovitug treatment, Change from Baseline in AST-to-platelet ratio index (APRI) at Weeks 24, 48, and 96 of brelovitug treatment, Change from Baseline in CTP score in cirrhotic participants at Weeks 24, 48, and 96 of brelovitug treatment, Change from Baseline in Model for End-Stage Liver Disease (MELD) score in cirrhotic participants at Weeks 24, 48, and 96 of brelovitug treatment, Proportion of participants with clinical disease progression from Baseline in HDV-associated liver disease at Weeks 24, 48 and 96 of brelovitug treatment. Progression will be determined by the Independent Data Monitoring Committee (IDMC).

Source: https://euclinicaltrials.eu/ctis-public/view/2025-522105-38-00